EU clinical trial 2023-508926-91-00: Randomized multi-centre open-label non-inferiority phase 3 clinical trial for patients with a stage IV childhood renal tumour comparing upfront Vincristine, Actinomycin-D and Doxorubicin (VAD, standard arm) with upfront Vincristine, Carboplatin and Etoposide (VCE, experimental arm)
Protocol code: Randomet2017
Sponsor: GPOH gGmbH (Patient organisation/association). Phase: Therapeutic confirmatory (Phase III). Countries: France (ongoing, recruiting), Belgium (ongoing, recruiting), Denmark (ongoing, recruiting), Netherlands (ongoing, recruiting), Germany (ongoing, recruiting), Austria (ongoing, recruiting), Czechia (ongoing, recruiting), Hungary (authorised, recruitment pending), Italy (authorised, recruitment pending), Spain (authorised, recruitment pending), Greece (authorised, recruitment pending).
Therapeutic area(s): Diseases [C] - Neoplasms [C04]
Gender: Female, Male. Age: 0-17 years. Enrolment: 409.
Start date (EU): 2019-12-05. Decision date: 2024-05-23. Results received: No. Last updated: 2026-06-09.
Decision dates by country: DK: 2024-05-23, DE: 2024-05-28, FR: 2024-05-24, AT: 2024-05-28, BE: 2024-05-24, NL: 2024-05-23, CZ: 2025-10-22, HU: 2025-11-07, IT: 2026-04-17, ES: 2026-05-04, GR: 2026-06-09

Condition(s): Stage IV childhood renal tumour with pulmonary +/- non-pulmonary metastasis
Product: Vincristine Sulfate 1 mg/ml Solution for Injection or Infusion, CARBOPLATIN, ETOPOSIDE, DOXORUBICIN, DACTINOMYCIN

Primary endpoint: Percentage of patients with radiologic complete response (CR) of any metastasis and/or Very Good Partial Response (VGPR) of lung metastasis of childhood renal tumours after 6 weeks of preoperative chemotherapy (Section 12.5 for definitions of metastatic response)
Endpoint(s): Percentage of patients after 6 weeks of preoperative chemotherapy achieving a CR after surgery of metastasis at time of nephrectomy, Percentage of patients with complete response +/- VGPR of (pulmonary) metastasis of nephroblastoma after 6 weeks of preoperative chemotherapy + 9 weeks adjuvant chemotherapy., Percentage of patients with complete response +/- VGPR of (pulmonary) metastasis of nephroblastoma after preoperative chemotherapy + 9 weeks adjuvant chemotherapy + metastasectomy, Percentage of patients with remaining metastatic disease after surgery that achieve a CR at week 9 of adjuvant chemotherapy, Percentage of patients with complete response +/- VGPR of (pulmonary) metastasis of nephroblastoma at the end of adjuvant chemotherapy ± metastasectomy ± RT, Percentage of patients with radiologic complete response (CR) of any metastasis or Very Good Partial Response (VGPR) of lung metastasis of nephroblastoma after 6 weeks of preoperative chemotherapy, Primary tumour volume shrinkage after 6 weeks of preoperative chemotherapy, Primary tumour volume after 6 weeks of preoperative chemotherapy, Number of metastases at diagnosis and after preoperative treatment, Maximum diameters of the largest metastases at diagnosis and after preoperative treatment, Stage distribution of local tumour, Histologic subtype distribution of local tumour (LR, IR, HR), Histologic subtype distribution of resected nodules/metastasis (LR, IR, HR), Percentage of blastema and blastemal residual volume in local tumour, Percentage of patients with <10 ml of blastemal residual volume in resected nephroblastoma after 6 weeks of preoperative chemotherapy, Percentage of necrosis in local tumour, Percentage of patients with complete necrosis in resected nodules, Percentage of patients with 1q gain being in CR/VGPR in both arms., Percentage of patients requiring pulmonary radiotherapy in first line, Percentage of patients suffering Grade 3 or 4 ALAT or bilirubin increase during preoperative treatment, Percentage of patients suffering from SOS during preoperative treatment according to EBMT criteria, Percentage of patients suffering any Grade 4 or grade 5 toxicity during preoperative chemotherapy, Overall duration of preoperative treatment per arm as determined as interval D1 – date of nephrectomy, Delay in timing of nephrectomy: % of patients with more than 8 weeks since start of preoperative chemotherapy because of toxicity, Percentage of (peri-)operative complications (haemorrhage, rupture, thromboembolism), Event-free survival at 2 and 5 years for the whole cohort and according to study arm (VAD/VCE) and according to 1qGain, Overall survival at 2 and 5 years for the whole cohort and according to study arm (VAD/VCE) and according to 1qGain

Source: https://euclinicaltrials.eu/ctis-public/view/2023-508926-91-00